EU clinical trial 2023-504884-17-00: (19920) A 6-month multicenter, randomized, double-blind, placebo-controlled study to evaluate the efficacy, safety and PK/PD of an age-and body weightadjusted oral finerenone regimen, in addition to an ACEI or ARB, for the treatment of children, 6 months to <18 years of age, with chronic kidney disease and proteinuria
Protocol code: 19920
Sponsor: Bayer AG (Pharmaceutical company). Phase: Therapeutic confirmatory (Phase III). Countries: Hungary (ended), Spain (ongoing, recruitment ended), Sweden (ended), France (ended), Greece (ongoing, recruitment ended), Finland (ongoing, recruitment ended), Germany (ended), Netherlands (ended), Poland (ended), Lithuania (ended), Portugal (ended), Denmark (ended), Italy (ongoing, recruitment ended), Belgium (ended), Austria (ended), Czechia (ended), Bulgaria (ongoing, recruitment ended).
Therapeutic area(s): Diseases [C] - Nutritional and Metabolic Diseases [C18]
Gender: Female, Male. Age: 0-17 years. Enrolment: 245.
Start date (EU): 2022-02-04. Decision date: 2024-03-18. Results received: No. Last updated: 2026-06-03.
Decision dates by country: SE: 2024-03-25, ES: 2024-03-19, DK: 2024-03-19, BE: 2024-03-27, CZ: 2024-03-22, FR: 2024-03-21, FI: 2024-03-20, PL: 2024-03-25, IT: 2024-03-21, DE: 2024-03-20, AT: 2024-04-16, NL: 2024-03-19, BG: 2025-11-24, PT: 2024-03-18, LT: 2024-03-28, HU: 2024-03-20, GR: 2024-06-03

Condition(s): Proteinuria, Chronic kidney disease
Product: Placebo to BAY 948862, BAY 94-8862, BAY 948862, Placebo to Finerenone 20 film-coated tablets, Placebo to Finerenone 10 film-coated tablets, Finerenone

Primary endpoint: Mean reduction from baseline to Month 6 in Urinary Protein-toCreatinine Ratio (Percent change from baseline to day 180±7 in UPCR)
Endpoint(s): Number of participants with a. AEs b. Serious TEAEs c. TEAEs and serious TEAEs leading to discontinuation of treatment d. Study drug related TEAEs and serious TEAEs e. TEAEs categorized by severity f. TEAEs by maximum intensity g. No. of participants hospitalized with hyperkalemia h. No. of participants discontinuing due to hyperkalemia i. No. of participants hospitalization for worsening of renal function j. No. of participants discontinuing due to worsening of renal function, Change in serum potassium levels, serum creatinine, eGFR and systolic blood pressure from baseline to day 180±7, Urinary Protein-to-Creatinine Ratio (UPCR) reduction of at least 30% from baseline to day 180±7 (Proportion of responders at the day 180±7 time point, where a responder is defined as a >=30% reduction in UPCR compared to baseline, Change in UACR from baseline to day 180±7, PK (finerenone Cmax,md, AUCτ,md) based on total concentrations in plasma, Taste and texture of the pediatric formulation

Source: https://euclinicaltrials.eu/ctis-public/view/2023-504884-17-00